EU clinical trial 2024-515553-17-00: Safety and efficacy of a bilateral single subretinal injection of rAAV.hCNGA3 in adult and minor patients with CNGA3-linked achromatopsia investigated in a randomized, wait list controlled, observer-masked trial (Colour Bridge)
Protocol code: RDC-CNGA3-01
Sponsor: Universitaetsklinikum Tuebingen AöR (Hospital/Clinic/Other health care facility). Phase: Phase I and Phase II (Integrated)- Other. Countries: Germany (ongoing, recruitment ended).
Therapeutic area(s): Diseases [C] - Eye Diseases [C11]
Gender: Female, Male. Age: 0-17 years, 18-64 years, 65+ years. Enrolment: 14.
Status: Ongoing, recruitment ended. Start date (EU): 2021-03-11. Decision date: 2024-07-16. Results received: No. Last updated: 2025-03-06.

Condition(s): CNGA3-linked achromatopsia
Product: rAAV.hCNGA3

Primary endpoint: Contrast sensitivity (Pelli Robson 3 m) 6 months after treatment
Endpoint(s): Contrast sensitivity (Pelli Robson 3 m), BCVA assessed using the ETDRS visual acuity protocol, FrACT (Freiburg Visual Acuity & Contrast Test), Roth FM28 sat, VA-CAL (Visual acuity under different conditions of contrast and ambient light), Patient reported outcomes (VFQ25/CVFQ, A3-PRO), Electroretinography, Chromatic pupil campimetry (CPC) cone protocol – exploratory - functional

Source: https://euclinicaltrials.eu/ctis-public/view/2024-515553-17-00